EU clinical trial 2023-507148-35-00: A Phase 3 Randomized Placebo-controlled Double-blind Study of Romiplostim for the Treatment of Chemotherapy-induced Thrombocytopenia in Patients Receiving Oxaliplatin-based Chemotherapy for Treatment of Gastrointestinal, Pancreatic, or Colorectal Cancer (RECITE)
Protocol code: 20140346
Sponsor: Amgen Inc. (Pharmaceutical company). Phase: Therapeutic confirmatory (Phase III). Countries: Spain (ended), Portugal (ended), France (ended), Italy (ended), Romania (ended), Greece (ended), Poland (ended), Bulgaria (ended).
Therapeutic area(s): Not possible to specify
Gender: Female, Male. Age: 18-64 years, 65+ years. Enrolment: 60.
Status: Ended. Start date (EU): 2019-10-03. End date (EU): 2025-01-09. End date: 2025-01-10. Decision date: 2023-11-13. Results received: Yes. Last updated: 2025-06-26.
Decision dates by country: RO: 2023-12-12, BG: 2023-12-21, PL: 2023-12-21, FR: 2023-11-30, GR: 2024-01-12, PT: 2023-11-14, ES: 2023-11-13, IT: 2023-12-01

Condition(s): Chemotherapy-induced Thrombocytopenia in Adult Subjects with Gastrointestinal, Pancreatic, or Colorectal Cancer
Product: Nplate 500 micrograms powder and solvent for solution for injection, Placebo will be provided in identical 5 mL single-use vials as a sterile, white, preservative-free, lyophilized powder containing histidine, mannitol, sucrose, and polysorbate 20 and has a pH 5.0 when reconstituted with sterile water for injection

Primary endpoint: No thrombocytopenia-induced modification of any myelosuppressive treatment agent in the second and third cycles of the planned on-study chemotherapy regimen. Thrombocytopenia-induced modifications include chemotherapy dose reduction, delay, omission, or chemotherapy treatment discontinuation due to platelet counts below 100 x 109/L
Endpoint(s): The depth of the platelet count nadir from the start of the first on-study chemotherapy cycle through the end of the treatment period, The time to first platelet response, defined by platelet count ≥ 100 x 109/L in the absence of platelet transfusions during the preceding 7 days, The duration-adjusted event rate of ≥ grade 2 bleeding events, as assessed by Common Terminology Criteria for Adverse Events (CTCAE) version 5.0 grading scale, Overall Survival, Platelet transfusion(s) during the treatment period, achieving a platelet count ≥ 100 x 109/L at any time after study day 1 to week 4 (ie, 7 days after the planned third dose of investigational product) and in the absence of platelet transfusions during the preceding 7 days, Adverse events, including treatment-emergent adverse events, fatal adverse events, serious adverse events, and clinically significant changes in laboratory values. Anti-romiplostim antibodies and antibodies to thrombopoietin (TPO) myelodysplastic syndromes and secondary malignancies

Source: https://euclinicaltrials.eu/ctis-public/view/2023-507148-35-00